EU clinical trial 2022-502328-35-00: A Phase 2 Study for the Treatment of Anemia with Alpha (α)-Thalassemia to Determine the Efficacy and Safety of Luspatercept (BMS-986346/ACE-536) in Adults and Evaluate the Safety and Pharmacokinetics in Adolescents
Protocol code: CA056-015
Sponsor: Celgene Corp. (Pharmaceutical company). Phase: Therapeutic exploratory (Phase II). Countries: Italy (ongoing, recruiting), Greece (ongoing, recruiting).
Therapeutic area(s): Diseases [C] - Hemic and Lymphatic Diseases [C15]
Gender: Female, Male. Age: 0-17 years, 18-64 years, 65+ years. Enrolment: 41.
Status: Ongoing, recruiting. Start date (EU): 2023-01-30. Decision date: 2023-07-04. Results received: No. Last updated: 2026-03-25.
Decision dates by country: GR: 2023-07-07, IT: 2023-07-04

Condition(s): Alpha (α)-thalassemia
Product: Reblozyl 75 mg powder for solution for injection, Reblozyl 25 mg powder for solution for injection, 0.9% sodium chloride injection, solution for injection

Primary endpoint: Adult cohorts, Primary endpoints: - TD: Achievement of ≥ 50% reduction from baseline in RBC transfusion burden with a reduction of at least 2 units during any continuous 12 weeks during Weeks 13-48 compared to the 12-week interval immediately prior to the date of first dose., Adult cohorts, Primary endpoints: - NTD: Achievement of an increase from baseline of ≥ 1.0 g/dL in mean hemoglobin values over the continuous 12-week interval from Week 13 to Week 24 in the absence of RBC transfusion., Adolescent cohorts, Primary endpoints: - Dose-limiting toxicities (DLTs) defined as observance of ≥ Grade 3-related hemolytic crises or ≥ Grade 3-related event outside of the known safety profile occurring within the 21 days from their first dose of study therapy. - PK parameters - Frequency, severity, and seriousness of AEs

Source: https://euclinicaltrials.eu/ctis-public/view/2022-502328-35-00